EU clinical trial 2023-506311-18-00: A Study Evaluating the Safety, Pharmacokinetics, and Activity of GDC-6036 as a Single Agent and in Combination with other Anti-Cancer Therapies in Patients with Advanced or Metastatic Solid Tumors with a KRAS G12C Mutation
Protocol code: GO42144
Sponsor: Genentech Inc. (Pharmaceutical company). Phase: Human Pharmacology (Phase I)- First administration to humans. Countries: Poland (ongoing, recruitment ended), Spain (ongoing, recruitment ended), Italy (ongoing, recruitment ended), Hungary (ended), Norway (ongoing, recruitment ended), Netherlands (ongoing, recruitment ended), Belgium (ongoing, recruitment ended).
Therapeutic area(s): Diseases [C] - Neoplasms [C04]
Gender: Female, Male. Age: 18-64 years, 65+ years. Enrolment: 156.
Start date (EU): 2021-06-29. Decision date: 2024-06-19. Results received: No. Last updated: 2026-07-30.
Decision dates by country: HU: 2024-06-19, ES: 2024-06-20, BE: 2024-06-19, IT: 2024-06-24, PL: 2024-07-05, NO: 2024-06-21, NL: 2024-06-19

Condition(s): Advanced or metastatic solid tumors with KRAS G12C mutation

Source: https://euclinicaltrials.eu/ctis-public/view/2023-506311-18-00